EU clinical trial 2025-521873-15-00: TulmiSTAR-02: A two-part Phase I dose escalation study of tulmimetostat (DZR123) in combination with darolutamide or abiraterone followed by open-label, randomized, Phase II dose expansion study to assess the safety and efficacy of tulmimetostat in combination with darolutamide versus darolutamide alone in patients with metastatic hormone-sensitive prostate cancer
Protocol code: CDZR123C12101
Sponsor: Novartis Pharma AG (Pharmaceutical company). Phase: Phase I and Phase II (Integrated)- Other. Countries: Hungary (ongoing, recruiting), Spain (ongoing, recruiting), Italy (ongoing, recruiting), Germany (ongoing, recruiting), France (ongoing, recruiting).
Therapeutic area(s): Diseases [C] - Neoplasms [C04]
Gender: Male. Age: 18-64 years, 65+ years. Enrolment: 54.
Status: Ongoing, recruiting. Start date (EU): 2026-02-09. Decision date: 2025-12-18. Results received: No. Last updated: 2026-02-27.
Decision dates by country: FR: 2025-12-18, DE: 2025-12-19, HU: 2025-12-18, ES: 2025-12-18, IT: 2026-02-09

Condition(s): Metastatic hormone-sensitive prostate cancer
Product: ABIRATERONE, DAROLUTAMIDE, DZR123, ABIRATERONE, DZR123, DAROLUTAMIDE

Primary endpoint: Phase I - Safety: DLTs during the first 28 days of combination treatment. Type, frequency and severity of AEs per CTCAE v5.0 and notable values in laboratory values, vital signs, and ECGs - Tolerability: Dose interruptions, dose reductions, drug discontinuations, dose intensity, and duration of exposure to study treatment (all study drugs) Phase II: BCR defined as PSA decline to < 0.2 ng/mL at 6 months, confirmed by a second PSA measurement ≥ 3 weeks later
Endpoint(s): Phase I: Plasma concentrations of tulmimetostat, darolutamide, and abiraterone, and derived PK parameters including AUC and Cmax Phase II: Radiographic progression free survival (rPFS), Overall survival (OS), Objective response (OR), Best overall response (BOR), Duration of response (DOR), PSA50 and Biochemical Response of <0.1 ng/mL, Time to castration–resistant prostate cancer (CRPC), Phase II: - Safety: Type, frequency and severity of treatment-emergent and treatment-related AEs per CTCAE version 5.0 and notable values in laboratory parameters, vital signs and ECGs - Tolerability: Dose interruptions, dose reductions, drug discontinuations, dose intensity, and duration of exposure to study treatment (all study drugs), Phase II: Plasma concentrations of tulmimetostat and darolutamide., Phase II: TTSSE defined as the time from randomization to the first new symptomatic pathological bone fracture, spinal cord compression, tumor-related orthopedic surgical intervention, requirement for radiation therapy to relieve bone pain or death from any cause, whichever occurs first

Source: https://euclinicaltrials.eu/ctis-public/view/2025-521873-15-00